EU clinical trial 2023-507035-37-00: A randomized double-blind placebo-controlled phase 1 study on the safety, tolerability and pharmacokinetics/-dynamics of escalating single intravenous doses of AK1967 (Procizumab) in healthy male volunteers
Sponsor: 4TEEN4 Pharmaceuticals GmbH (Pharmaceutical company). Phase: Human Pharmacology (Phase I)- First administration to humans. Countries: Netherlands (ended).
Therapeutic area(s): Diseases [C] - Cardiovascular Diseases [C14]
Gender: Male. Age: 18-64 years. Enrolment: 24.
Status: Ended. Start date (EU): 2024-03-11. End date (EU): 2024-07-05. Decision date: 2024-02-21. Results received: No. Last updated: 2024-02-21.

Condition(s): Circulatory shock

Source: https://euclinicaltrials.eu/ctis-public/view/2023-507035-37-00